EU clinical trial 2023-506197-12-00: A Phase IIb, Multicenter, Randomized, Parallel-group, Double- blind, Placebo-controlled, Dose-ranging Study to Evaluate the Efficacy, Safety, and Tolerability of AZD0780 in Participants with Dyslipidemia
Protocol code: PURSUIT
Sponsor: Astrazeneca AB (Pharmaceutical company). Phase: Therapeutic exploratory (Phase II). Countries: Denmark (ended), Czechia (ended), Spain (ended), Slovakia (ended), Hungary (ended).
Therapeutic area(s): Diseases [C] - Cardiovascular Diseases [C14]
Gender: Female, Male. Age: 18-64 years, 65+ years. Enrolment: 209.
Status: Ended. Start date (EU): 2024-02-07. End date (EU): 2024-09-25. End date: 2024-10-01. Decision date: 2024-01-16. Results received: Yes. Last updated: 2024-04-12.
Decision dates by country: HU: 2024-04-12, SK: 2024-01-19, DK: 2024-01-16, ES: 2024-01-16, CZ: 2024-01-17

Condition(s): Dyslipidemia Dyslipidemias are alterations to the plasma lipid profile associated often with clinical condition. A common form of dyslipidemia is Hypercholesterolemia due to high level of LDL-cholesterol, which is a major risk factor for Cardiovascular Disease (CVD), such as Ischemic Heart Disease and Ischemic Stroke. CVD is a leading cause of global mortality and a contributor to disability.
Product: AZD0780, AZD0780, AZD0780 Placebo, AZD0780

Primary endpoint: Percent change from baseline of Low-Density Lipoprotein cholesterol (LDL-C) at Week 12
Endpoint(s): Percent change from baseline of Low-Density Lipoprotein cholesterol (LDL-C) at Week 12, AZD0780 plasma concentrations summarized by sampling timepoint, Percent change from baseline at Week 12 in, total cholesterol, high-density lipoprotein cholesterol (HDL-C), triglycerides, non-high-density lipoprotein cholesterol (Non-HDL-C), very low-density lipoprotein cholesterol (VLDL-C), apolipoprotein A-1 (ApoA1), apolipoprotein B-100 (ApoB), lipoprotein (a) (Lp(a)), remnant cholesterol, and high-sensitivity C-reactive protein (hsCRP)., Percent change from baseline at Week 12 in, total cholesterol, high-density lipoprotein cholesterol (HDL-C), triglycerides, non-high-density lipoprotein cholesterol (Non-HDL-C), very low-density lipoprotein cholesterol (VLDL-C), apolipoprotein A-1 (ApoA1), apolipoprotein B-100 (ApoB), lipoprotein (a) (Lp(a)), remnant cholesterol, and high-sensitivity C-reactive protein (hsCRP)., Safety and tolerability will be assessed in terms of adverse events, vital signs, electrocardiogram (ECG), and clinical laboratory evaluations

Source: https://euclinicaltrials.eu/ctis-public/view/2023-506197-12-00